EU clinical trial 2023-510203-21-00: Phase I/II First-In-Human open-label trial to assess safety and efficacy of STX-241 in participants with locally advanced or metastatic non-small cell lung cancer (NSCLC) resistant to EGFR tyrosine kinase inhibitors (TKIs)
Protocol code: F60087CI101
Sponsor: Pierre Fabre Medicament (Pharmaceutical company). Phase: Phase I and Phase II (Integrated)- First administration to humans. Countries: Spain (ongoing, recruiting), Netherlands (ongoing, recruiting), France (ongoing, recruiting), Germany (ongoing, recruiting).
Therapeutic area(s): Diseases [C] - Neoplasms [C04]
Gender: Female, Male. Age: 18-64 years, 65+ years. Enrolment: 79.
Status: Ongoing, recruiting. Start date (EU): 2024-09-24. Decision date: 2024-09-05. Results received: No. Last updated: 2026-08-07.
Decision dates by country: ES: 2024-09-05, DE: 2024-09-05, NL: 2024-09-05, FR: 2024-09-30

Condition(s): locally advanced or metastatic non-small cell lung cancer (NSCLC) resistant to EGFR tyrosine kinase inhibitors (TKIs)

Primary endpoint: Part 1: Safety: Incidence and severity of TEAEs/SAEs including changes in physical examination, vital signs, laboratory values, LVEFs and ECGs, according to NCI-CTCAE v5.0 criteria., Part 1: Tolerability: TEAEs/SAEs leading to STX-241 dose reductions, interruptions or discontinuations., Part 1: OBD: Incidence of DLTs during Cycle 1, PK exposure, tumor shrinkage, TEAEs/SAEs ≥ Grade 2. Type, frequency, and severity of TEAEs/SAEs according to National Cancer Institute (NCI) Common Terminology Criteria for Adverse Events (CTCAE) v5.0 criteria., Part 1: MTD: Incidence of Dose-Limiting Toxicities (DLTs) during Cycle 1 (i.e. the first 28 days of treatment per dose level)., Part 2: Overall safety, PK exposure, PD, confirmed ORR (cORR)by IR, Part 2: Safety: incidence and severity of TEAEs/SAEs including changes in laboratory values, physical examination, vital signs, LVEFs and ECGs according to NCI-CTCAE v5.0 criteria, Part 2: Tolerability: STX-241 dose reductions, interruptions or discontinuations.
Endpoint(s): Part 1: PK exposure parameters (e.g. Cmax, Tmax, AUC0-tau, AUC0-t, AUC0-∞, t½, λz, CL/F, Vz/F, Rac for Cmax and AUC, and Ctrough)., Part 1: cORR, DCR, TTR and DOR by Investigator Review (IR) in accordance to Response Evaluation Criteria in Solid Tumors (RECIST version 1.1)., Part 2: DCR, TTR, DOR, and PFS by RECIST v1.1 by IR., Part 2: Overall Survival (OS)., Part 2: PK exposure parameters (e.g. Cmax, Tmax, AUC0-tau, AUC0-t, AUC0-∞, t½, λz, CL/F, Vz/F, Rac for Cmax and AUC, and Ctrough).

Source: https://euclinicaltrials.eu/ctis-public/view/2023-510203-21-00